EU clinical trial 2024-516901-21-00: A Trial Comparing Pharmacokinetics, Safety and Tolerability of Two Subcutaneous Concentrations of Dapiglutide
Protocol code: ZP7570-24026
Sponsor: Zealand Pharma A/S (Pharmaceutical company). Phase: Human Pharmacology (Phase I)- Other. Countries: Germany (ended).
Therapeutic area(s): Diseases [C] - Nutritional and Metabolic Diseases [C18]
Gender: Female, Male. Age: 18-64 years. Enrolment: 34.
Status: Ended. Start date (EU): 2024-12-23. End date (EU): 2025-04-25. Decision date: 2024-12-10. Results received: No. Last updated: 2025-04-09.

Condition(s): Weight management

Source: https://euclinicaltrials.eu/ctis-public/view/2024-516901-21-00